EU clinical trial 2024-519299-16-00: A 2-Part, Phase 3, Multicenter, Randomized, Open-Label, Active-Controlled Study to Assess Efficacy and Safety of REGN7508, a Monoclonal Antibody Against Factor XI, for the Treatment and Secondary Prevention of Venous Thromboembolism in Participants with Solid and Hematologic Cancers (ROXI-CAT-II)
Protocol code: R7508-CAT-2396
Sponsor: Regeneron Pharmaceuticals Inc. (Pharmaceutical company). Phase: Therapeutic confirmatory (Phase III). Countries: Bulgaria (authorised, recruitment pending), Romania (authorised, recruitment pending).
Therapeutic area(s): Diseases [C] - Cardiovascular Diseases [C14]; Diseases [C] - Hemic and Lymphatic Diseases [C15]
Gender: Female, Male. Age: 18-64 years, 65+ years. Enrolment: 164.
Status: Authorised, recruitment pending. Decision date: 2026-06-26. Results received: No. Last updated: 2026-06-29.
Decision dates by country: BG: 2026-06-26, RO: 2026-06-29

Condition(s): Cancer Associated Thrombosis
Product: Eliquis 2.5 mg film-coated tablets, Eliquis 5 mg film-coated tablets, REGN7508

Primary endpoint: Part 1: Occurrence of Treatment-Emergent Adverse Events (TEAEs), Part 1: Severity of TEAEs, Part 2: Time-to-first event of centrally adjudicated recurrent VTE [DVT (symptomatic or asymptomatic [proximal] or Non-fatal PE (symptomatic or asymptomatic [in a segmental or larger pulmonary artery] )or VTE-related death)], Part 2: Time-to-first event of centrally adjudicated International Society of Thrombosis and Hemostasis (ISTH)-defined major bleeding or Clinically Relevant Non-Major (CRNM) bleeding
Endpoint(s): Part 1: Percent inhibition of Factor XI functional Coagulant activity (FXI:C), Part 1: Fold change from baseline in activated Partial Thromboplastin Time (aPTT), Part 1: Functional REGN7508 concentration, Part 1: Factor XI (FXI) concentration, Part 1 and 2: Occurrence of Anti-Drug Antibody (ADA) to REGN7508, Part 1 and 2: Magnitude of ADA to REGN7508, Part 2: Time-to-first centrally adjudicated event of DVT (symptomatic or asymptomatic [proximal]), Part 2: Time-to-first centrally adjudicated event of Non-fatal PE (symptomatic or asymptomatic [in a segmental or larger pulmonary artery]), Part 2: Time-to-first centrally adjudicated event of VTE-related death, Part 2: Time-to-first event of centrally adjudicated venous thromboembolic events other than DVT and PE, Part 2: Time-to-first event of centrally adjudicated Arterial Thromboembolism (ATE), Part 2: Time-to-first event of centrally adjudicated recurrent VTE and bleeding events [DVT (symptomatic or asymptomatic [proximal] or Non-fatal PE (symptomatic or asymptomatic) or VTE-related death) or bleeding (ISTH-defined major bleeding or CRNM bleeding)], Part 2: Occurrence of TEAEs, Part 2: Severity of TEAEs

Source: https://euclinicaltrials.eu/ctis-public/view/2024-519299-16-00